EU clinical trial 2023-509752-34-00: Evaluation of bioequivalence of two products containing 400 mg ibuprofen and 100 mg caffeine: Ibuprofen / Caffeine 400 mg / 100 mg coated granules (Test) vs. Thomapyrin TENSION DUO, 400mg / 100mg Filmtabletten (Reference). A monocentric, open, randomized, single dose, two-period, crossover trial in healthy volunteers
Sponsor: CCDRD Cooperative Clinical Drug Research and Development AG, Hermes Pharma GmbH (Pharmaceutical company). Phase: Human Pharmacology (Phase I)- Bioequivalence Study. Countries: Bulgaria (ended).
Therapeutic area(s): Not possible to specify
Gender: Female, Male. Age: 18-64 years. Enrolment: 28.
Status: Ended. Start date (EU): 2024-09-07. End date (EU): 2024-09-23. Decision date: 2024-08-09. Results received: No. Last updated: 2024-08-09.

Condition(s): No therapeutic indication in the current trial with healthy volunteers.

Source: https://euclinicaltrials.eu/ctis-public/view/2023-509752-34-00